EU clinical trial 2024-512385-34-00: Neurodevelopmental outcome after standard dose sevoflurane versus low-dose sevoflurane/dexmedetomidine/remifentanil anaesthesia in young children
Protocol code: TREX
Sponsor: Giannina Gaslini Institute For Scientific Hospitalization And Care (Hospital/Clinic/Other health care facility). Phase: Therapeutic confirmatory (Phase III). Countries: Italy (ongoing, recruiting).
Therapeutic area(s): Analytical, Diagnostic and Therapeutic Techniques and Equipment [E] - Anesthesia and Analgesia [E03]
Gender: Female, Male. Age: 0-17 years. Enrolment: 150.
Status: Ongoing, recruiting. Start date (EU): 2020-09-30. Decision date: 2024-07-09. Results received: No. Last updated: 2024-07-09.

Condition(s): Children under the age of 2 years having surgery lasting at least 2 hours
Product: SEVOFLURANE, DEXMEDETOMIDINE HYDROCHLORIDE

Primary endpoint: Full scale IQ score of the Wechsler Preschool and Primary School Intelligence Scale assessed
Endpoint(s): Neuropsychological tests • Language (Test TLV - Language evaluation) • Attention/Executive Function/impulse control: (NEPSY-2: Statue Subtest) • Memory: (NEPSY-2: Narrative memory) • Adaptive Behaviour: (Adaptive Behavior Assessment System, 2rd Ed 0-5 years) • Clinical Behaviour: (Child Behavior Checklist for ages 1.5-5 years) • Executive Function: (Behavior Rating of Executive Function- Preschool), Anaesthesia - Incidence of intra-operative hypotension - Intra-operative bradycardia - Post-operative pain (FLACC Scale: Face, Legs, Activity, Cry, Consolability Scale) - Time to recovery, Safety - Nature and incidence of adverse events and serious adverse events

Source: https://euclinicaltrials.eu/ctis-public/view/2024-512385-34-00